EU clinical trial 2024-520353-21-00: A Phase 1, Open-Label, Multicenter Study of INCB160058 in Participants With Myeloproliferative Neoplasms.
Protocol code: INCB160058-101
Sponsor: Incyte Corp. (Pharmaceutical company). Phase: Human Pharmacology (Phase I)- Other. Countries: Norway (ended), Germany (ended), France (ended), Italy (ended).
Therapeutic area(s): Diseases [C] - Neoplasms [C04]
Gender: Female, Male. Age: 18-64 years, 65+ years. Enrolment: 120.
Status: Ended. Start date (EU): 2026-02-24. End date (EU): 2026-07-23. Decision date: 2026-01-14. Results received: No. Last updated: 2026-05-22.
Decision dates by country: NO: 2026-01-15, IT: 2026-01-16, DE: 2026-01-16, FR: 2026-01-14

Condition(s): Myeloproliferative Neoplasms

Source: https://euclinicaltrials.eu/ctis-public/view/2024-520353-21-00